EU clinical trial 2022-500820-31-00: A Phase 2, randomized, open-label three-arm clinical study to evaluate the safety and efficacy of lenvatinib (E7080/MK-7902) in combination with pembrolizumab (MK-3475) versus standard of care chemotherapy and lenvatinib monotherapy in participants with recurrent/metastatic head and neck squamous cell carcinoma (R/M HNSCC) that have progressed after platinum therapy and immunotherapy (PD-1/PD-L1 inhibitors) (LEAP-009)
Protocol code: MK-7902-009
Sponsor: Merck Sharp & Dohme LLC (Pharmaceutical company). Phase: Therapeutic exploratory (Phase II). Countries: Norway (ended), Denmark (ended), Portugal (ended), Romania (ended), Spain (ended), France (ended).
Therapeutic area(s): Diseases [C] - Neoplasms [C04]
Gender: Female, Male. Age: 18-64 years, 65+ years. Enrolment: 158.
Status: Ended. Start date (EU): 2020-07-16. End date (EU): 2025-09-02. End date: 2025-10-30. Decision date: 2024-04-29. Results received: No. Last updated: 2025-09-22.
Decision dates by country: FR: 2024-05-06, PT: 2024-04-29, DK: 2024-04-29, RO: 2024-05-07, NO: 2024-04-30, ES: 2024-04-29

Condition(s): Recurrent or metastatic squamous cell carcinoma of the head and neck
Product: DOCETAXEL, PACLITAXEL, KEYTRUDA 25 mg/mL concentrate for solution for infusion, CAPECITABINE, CETUXIMAB, Lenvatinib, Lenvatinib

Primary endpoint: Overall Survival (OS)
Endpoint(s): Progression-Free Survival (PFS), Objective Response Rate (ORR), Duration of Response (DOR), Number of Participants Who Experienced One or More Adverse Events (AEs), Number of Participants Who Discontinued Study Intervention Due to an Adverse Event (AE)

Source: https://euclinicaltrials.eu/ctis-public/view/2022-500820-31-00